EU clinical trial 2023-503831-17-00: A Phase 2 Study of Olaparib in Combination with Pembrolizumab in Participants with Previously Treated, Homologous Recombination Repair Mutation (HRRm) and/or Homologous Recombination Deficiency (HRD)-Positive Advanced Cancer
Protocol code: MK-7339-007
Sponsor: Merck Sharp & Dohme LLC (Pharmaceutical company). Phase: Therapeutic exploratory (Phase II). Countries: Sweden (ended), Italy (ended), Germany (ended), Spain (ended), Romania (ended), Poland (ended), France (ended), Latvia (ended).
Therapeutic area(s): Diseases [C] - Neoplasms [C04]
Gender: Female, Male. Age: 18-64 years, 65+ years. Enrolment: 107.
Status: Ended. Start date (EU): 2019-12-23. End date (EU): 2026-06-08. End date: 2026-06-09. Decision date: 2023-08-10. Results received: No. Last updated: 2026-06-04.
Decision dates by country: LV: 2023-08-31, IT: 2023-08-11, SE: 2023-08-10, RO: 2023-09-05, ES: 2023-08-14, FR: 2023-08-28, PL: 2023-09-05, DE: 2023-08-11

Condition(s): The treatment of participants with HRRm and/or HRD-positive cancer
Product: KEYTRUDA 25 mg/mL concentrate for solution for infusion, Olaparib, Olaparib

Primary endpoint: Objective Response Rate (ORR) as Assessed by Response Evaluation Criteria in Solid Tumors Version 1.1 (RECIST 1.1) or Prostate Cancer Working Group (PCWG)-modified RECIST 1.1 in Biomarker Subgroups
Endpoint(s): Duration of Response (DOR) as Assessed by RECIST 1.1 or PCWG-modified RECIST 1.1 in Biomarker Subgroups, Progression-Free Survival (PFS) as Assessed by RECIST 1.1 or PCWG-modified RECIST 1.1 in Biomarker Subgroups, Overall Survival (OS) in Biomarker Subgroups, Number of Participants Who Experience an Adverse Event (AE), Number of Participants Who Discontinue Study Treatment Due to an Adverse Event (AE), Objective Response Rate (ORR) Based on Tumor Biomarker Status as Assessed by RECIST 1.1 or PCWG-modified RECIST 1.1 in Additional Biomarker Subpopulations, Duration of Response (DOR) Based on Tumor Biomarker Status as Assessed by RECIST 1.1 or PCWG-modified RECIST 1.1 in Additional Biomarker Subpopulations, Progression-Free Survival (PFS) Based on Tumor Biomarker Status as Assessed by RECIST 1.1 or PCWG-modified RECIST 1.1 in Additional Biomarker Subpopulations, Overall Survival (OS) in Additional Biomarker Subpopulations, Number of Participants with Cancer Antigen-125 (CA-125) Level of ≥2 × Upper Limit of Normal (ULN) Among Participants with Ovarian Cancer, Number of Participants with Cancer Antigen-125 (CA-125) Level ≥2 × Nadir (Lowest) Value Among Participants with Ovarian Cancer Who Had Elevated CA-125 Levels ≥ULN at Baseline, Number of Participants with a Change from Baseline in Prostate-Specific Antigen (PSA) Level of ≥50% Among Participants with Prostate Cancer

Source: https://euclinicaltrials.eu/ctis-public/view/2023-503831-17-00